EU clinical trial 2024-514777-22-00: A First-in-Human Study to Evaluate the Safety and Anti-cancer Activity of the product FS120, which is an Antibody medication, to be administered alone or with Pembrolizumab in Subjects with Advanced Malignancies
Protocol code: FS120-19101
Sponsor: Invox Pharma Limited (Pharmaceutical company). Phase: Human Pharmacology (Phase I)- First administration to humans. Countries: Spain (ended).
Therapeutic area(s): Diseases [C] - Neoplasms [C04]
Gender: Female, Male. Age: 18-64 years, 65+ years. Enrolment: 113.
Status: Ended. Start date (EU): 2022-02-07. End date (EU): 2025-01-23. Decision date: 2024-07-18. Results received: No. Last updated: 2024-07-18.

Condition(s): Advanced Malignancies

Source: https://euclinicaltrials.eu/ctis-public/view/2024-514777-22-00